EU clinical trial 2023-509336-25-00: A Phase 1/2 Study of EPI-7386 in Combination with Enzalutamide Compared with Enzalutamide Alone in Subjects with Metastatic Castration-Resistant Prostate Cancer
Protocol code: EPI-7386-CS-010
Sponsor: Essa Pharma Inc. (Pharmaceutical company). Phase: Phase I and Phase II (Integrated)- Other. Countries: Spain (ended), Belgium (ended), France (ended).
Therapeutic area(s): Diseases [C] - Male Urogenital Diseases [C12]; Diseases [C] - Neoplasms [C04]
Gender: Male. Age: 18-64 years, 65+ years. Enrolment: 50.
Status: Ended. Start date (EU): 2024-06-12. End date (EU): 2024-10-31. End date: 2024-11-01. Decision date: 2024-04-24. Results received: Yes. Last updated: 2024-10-01.
Decision dates by country: ES: 2024-04-29, FR: 2024-04-24, BE: 2024-04-29

Condition(s): Metastatic castration-resistant prostate cancer
Product: EPI-7386, Xtandi - 40 mg soft capsules

Primary endpoint: Phase 1: The incidence of protocol-defined DLTs during the DLT assessment period (first cycle). The DLTs will be characterized by type, frequency, severity (as graded by National Cancer Institute Common Terminology Criteria for AEs [NCI CTCAE version 5.0]), timing in relation to study treatment administration, seriousness, and relationship to study treatment., Phase 1: TEAEs (characterized by type, frequency, severity, timing, seriousness, and relationship to study treatment)., Phase 1: Abnormalities in clinical laboratory parameters, vital sign measurements, and ECGs (characterized by type, frequency, severity, timing, seriousness, and relationship to study treatment)., Phase 1: Changes in ECOG performance status., Phase 2: The proportion of subjects with a prostate-specific antigen decline of >90% (PSA90).

Source: https://euclinicaltrials.eu/ctis-public/view/2023-509336-25-00